EU clinical trial 2023-505377-32-00: HOVON 170 DLBCL: ANTICIPATE: Prevention of ANThracycline-Induced Cardiac dysfunction by dexrazoxane In PATients with diffusE large B-cell lymphoma: a phase III national multicenter prospective randomized phase III trial
Sponsor: Stichting Hemato-Oncologie voor Volwassenen Nederland (Hovon) (Hospital/Clinic/Other health care facility). Phase: Therapeutic confirmatory (Phase III). Countries: Netherlands (ongoing, recruiting).
Therapeutic area(s): Diseases [C] - Hemic and Lymphatic Diseases [C15]
Gender: Female, Male. Age: 18-64 years, 65+ years. Enrolment: 324.
Status: Ongoing, recruiting. Start date (EU): 2024-08-15. Decision date: 2024-05-13. Results received: No. Last updated: 2026-04-21.

Condition(s): Diffuse large B-cell lymphoma (DLBCL)
Product: DOXORUBICIN HYDROCHLORIDE, RITUXIMAB, VINCRISTINE, PEGFILGRASTIM, LENALIDOMIDE, PREDNISOLONE, VINCRISTINE SULFATE, PREDNISOLONE, DOXORUBICIN, DOXORUBICIN HYDROCHLORIDE, Cardioxane 500 mg poeder voor oplossing voor infusie., LENALIDOMIDE, DOXORUBICIN HYDROCHLORIDE, DOXORUBICIN HYDROCHLORIDE, LENALIDOMIDE, DOXORUBICIN HYDROCHLORIDE, RITUXIMAB, CYCLOPHOSPHAMIDE, CYCLOPHOSPHAMIDE, DOXORUBICIN HYDROCHLORIDE, LENALIDOMIDE, LENALIDOMIDE, LENALIDOMIDE, VINCRISTINE, LENALIDOMIDE, CYCLOPHOSPHAMIDE

Primary endpoint: The incidence of AICD (measured with 2D) within 12-months after registration., Complete metabolic remission (CMR) on 18F-FDG PET-CT at end of treatment 6-8 weeks after completion of 6x R-CHOP21.
Endpoint(s): Overall survival (OS) at 12-months., Progression-free survival (PFS) at 12-months., LVEF (2D and 3D) and global longitudinal strain (GLS) at end of treatment and 12-months after start of treatment., NYHA functional class., Release of cardiac biomarkers., Quality of Life score., Safety and toxicity as defined by type, frequency and severity of adverse events as defined by the National Cancer Institute (NCI) Common Terminology Criteria for Adverse Events (CTCAE) version 5.0., Incidence of secondary malignancies., Major Adverse Cardiovascular Events (MACE) at 1-, 2-, 5- and 10-years.

Source: https://euclinicaltrials.eu/ctis-public/view/2023-505377-32-00